EU clinical trial 2024-515460-31-00: PIO2STOP_Combination study of Pioglitazone and Tyrosine Kinase Inhibitors (TKIs) in Chronic Myeloid Leukemia patients after failure of a TKIs discontinuation attempt in order to prepare a new stop.
Protocol code: PIO2STOP_P16/05
Sponsor: Centre Hospitalier De Versailles (Hospital/Clinic/Other health care facility). Phase: Therapeutic exploratory (Phase II). Countries: France (ongoing, recruitment ended).
Therapeutic area(s): Diseases [C] - Hemic and Lymphatic Diseases [C15]
Gender: Female, Male. Age: 18-64 years, 65+ years. Enrolment: 24.
Status: Ongoing, recruitment ended. Start date (EU): 2016-11-07. Decision date: 2024-10-10. Results received: No. Last updated: 2024-10-10.

Condition(s): CHRONIC PHASE CHRONIC MYELOGENOUS LEUKAEMIA
Product: Actos 30 mg tablets

Primary endpoint: Safety: To describe adverse events (AE) in subjects receiving the combination of PIO and TKI. AEs will be graded ac cording to the Common Terminology Criteria for Adverse Events (CTCAE) v.4.03 assessed through scheduled assessment and subject reported diary. To evaluate the pharmacokinetic parameters of pioglitazone and TKIs., Efficacy : To determine the proportion of subjects who maintain MMR over a 12 months period following discontinuation of PIO and TKI using blood qRT-PCR for BCR-ABL1 obtained monthly for the first 6 months, quarterly following 6 months, and bi-annually the second year, thereafter , in accordance of the center policy.

Source: https://euclinicaltrials.eu/ctis-public/view/2024-515460-31-00